EU clinical trial 2025-522297-36-00: Randomized, open-label, three-period crossover study on the palatability of oral dispersible formulations of Zonisamide in healthy volunteers.
Protocol code: DC03ZON/1/25
Sponsor: Noucor Health S.A. (Pharmaceutical company). Phase: Human Pharmacology (Phase I)- Other. Countries: Spain (ended).
Therapeutic area(s): Not possible to specify
Gender: Female, Male. Age: 18-64 years. Enrolment: 16.
Status: Ended. Start date (EU): 2025-09-03. End date (EU): 2025-11-06. Decision date: 2025-08-20. Results received: No. Last updated: 2025-08-20.

Condition(s): Healthy volunteers

Source: https://euclinicaltrials.eu/ctis-public/view/2025-522297-36-00